EU clinical trial 2024-518179-76-00: Randomized, multi-center, double-blind, two-armed, parallel active groups, prospective trial, to evaluate, in pediatric population undergoing 'Calcaneo stop' surgery or Inguinal hernia repair, the efficacy and safety of chloroprocaine 1% and 2% for peripheral nerve block based on concentration-response relationships.
Protocol code: CHL.2/04-2015
Sponsor: Sintetica S.A. (Pharmaceutical company). Phase: Therapeutic exploratory (Phase II). Countries: Italy (ended).
Therapeutic area(s): Not possible to specify
Gender: Female, Male. Age: 0-17 years. Enrolment: 174.
Status: Ended. Start date (EU): 2019-03-11. End date (EU): 2025-10-17. Decision date: 2024-11-05. Results received: Yes. Last updated: 2025-08-26.

Condition(s): Calcagno stop and inguinal hernia repair
Product: CHLOROPROCAINE HYDROCHLORIDE, MIDAZOLAM, CHLOROPROCAINE HYDROCHLORIDE, FENTANYL, TRAMADOL, PARACETAMOL, SEVOFLURANE

Primary endpoint: The primary efficacy endpoint of the study will be represented by the overall proportion of patients, in each of the two dosage level groups, not requiring rescue anesthesia during surgery.
Endpoint(s): 1 Proportion of patients, in both of the two dosage level groups, not requiring rescue anaesthesia (fentanyl) during the two surgical procedures separately;, 2 Time to onset of sensory block, defined as the time period from completion of the injection (time 0 min) to the achievement of complete sensory block, assessed by pinprick test associated with heart rate measurement, and evaluated for both surgeries;, 3 Time to regression of motor block evaluated in ‘calcaneo stop’ surgery only and assessed by a grade I of the standard Bromage scale (i.e. free movement of legs and feet). This evaluation will be performed immediately after the awakening and it will be repeated 30 minutes, 1 hour, 2 hours and 3 hours after the first evaluation, as well as during the visit for discharge, 4 (a) Pain intensity evaluated five times in the first 3 hours after patient’s awakening and during the home discharge visit (V2). Post-surgery assessment will be performed immediately after the awakening and it will be repeated 30 minutes, 1 hour, 2 hours and 3 hours after the first evaluation., 4 (b)The technique and appropriate scale for pain measurement are age-dependent therefore, different tools will have to be used for the evaluation: -COMFORT scale for patients <2 months of age; -FLACC scale for patients aged = 2 months = 6 years; -Wong-Baker scale for patients over 6 years of age;, 5 Time to eligibility for home discharge, defined as: “the time elapsed from completion of surgery to the time when criteria for discharge are met, regardless if the patient will be discharged from the hospital at a later time, according to the hospital procedures”. The criteria for discharge will be defined according with the Pediatric Post Anesthesia Discharge Scoring System (Ped-PADSS), 6 Time from completion of IMP injection to rescue anaesthesia, whenever required 7 Posology of rescue anaesthesia, whenever required 8 Proportion of patients requiring additional analgesia (Tramadol) after surgery, other than paracetamol i.v. administered after the surgery as per hospital’s standard procedures, 9 Type and posology of rescue analgesia required during the 7 days after surgery for each one of the two surgical procedures Safety: 10 Patient general recovery, evaluated by the Investigator through the evaluation questionnaire on the day of the intervention, 11 Patient general recovery, evaluated by the Investigator or his deputy through the F.U 24 H evaluation questionnaire on the day after intervention 12 Patient general recovery, evaluated by the Investigator or his deputy through the F.U 7-day evaluation questionnaire 7 days after intervention, 13 Overall proportion and 95% CI of patients with prolonged post-operative temporary loss of sensation and/or motor activity 14 Vital signs at rest (heart rate, systolic/diastolic blood pressure, respiratory rate, body temperature), 15 Proportion of patients with AE, in each of the two dosage level groups and in the two surgical procedures 16 Summaries of adverse events (AEs), including pain at injection site, neurological symptoms(such as: convulsion) and cardiac symptoms (such as bradycardia and heart failure etc.) evaluated, during surgery, after IMP injection

Source: https://euclinicaltrials.eu/ctis-public/view/2024-518179-76-00